EU clinical trial 2024-513968-25-00: A Phase 3, Open-label, Multicenter, Randomized Study of Xaluritamig vs Cabazitaxel or Second Androgen Receptor-Directed Therapy in Subjects With Metastatic Castration-Resistant Prostate Cancer Previously Treated With Chemotherapy
Protocol code: 20230005
Sponsor: Amgen Inc. (Pharmaceutical company). Phase: Therapeutic confirmatory (Phase III). Countries: Italy (ongoing, recruitment ended), Greece (ongoing, recruitment ended), France (ongoing, recruitment ended), Belgium (ongoing, recruitment ended), Spain (ongoing, recruitment ended), Sweden (ongoing, recruitment ended), Denmark (ongoing, recruitment ended), Netherlands (ongoing, recruitment ended), Poland (ongoing, recruitment ended), Austria (ongoing, recruitment ended), Germany (ongoing, recruitment ended).
Therapeutic area(s): Diseases [C] - Neoplasms [C04]
Gender: Male. Age: 18-64 years, 65+ years. Enrolment: 344.
Status: Ongoing, recruitment ended. Start date (EU): 2025-04-28. Decision date: 2025-04-07. Results received: No. Last updated: 2026-06-29.
Decision dates by country: FR: 2025-04-08, ES: 2025-04-08, AT: 2025-04-08, DK: 2025-04-07, PL: 2025-04-14, BE: 2025-04-07, NL: 2025-04-08, IT: 2025-04-09, GR: 2025-04-10, DE: 2025-04-10, SE: 2025-04-08

Condition(s): Metastatic castration-resistant prostate cancer (mCRPC)
Product: AMG 509, ABIRATERONE ACETATE, AMG 509, ENZALUTAMIDE, SYLVANT 400 mg powder for concentrate for solution for infusion, AMG 509, CABAZITAXEL, ABIRATERONE ACETATE

Primary endpoint: Overall survival
Endpoint(s): Radiographic progression-free survival per Prostate Cancer Working Group 3 (PCWG3)-modified RECIST v1.1, as assessed by blinded independent central review (BICR), Objective response per modified RECIST v1.1, as assessed by BICR, Duration of response (DOR) per RECIST v1.1, as assessed by BICR, Disease control per modified RECIST v 1.1 as assessed by BICR, Time to Response (TTR) per modified RECIST v1.1, as assessed by BICR, Time to first symptomatic skeletal events, Treatment Emergent Adverse Events, Treatment Emergent Serious Adverse Events, and fatal adverse events, Change from baseline in: - Brief Pain Inventory - Short Form Worst pain score - BPI-SF Pain intensity scale - BPI-SF Pain interference scale - Functional Assessment of Cancer Therapy – Prostate Total score and subscale scores - European Quality of Life - 5 Domain 5 Level Scale Utility score - Change from baseline in the EQ-5D-5L Visual Analogue Scale, Time to worsening in: - Brief Pain Inventory - Short Form Worst pain score - Brief Pain Inventory - Short Form Pain intensity scale - Brief Pain Inventory - Short Form Pain interference scale - Functional Assessment of Cancer Therapy – Prostate Total score, Time to pain improvement in: - Subjects with moderate/severe pain at baseline, Time to improvement after worsening in: - Brief Pain Inventory - Short Form Pain intensity scale - Brief Pain Inventory - Short Form Pain interference scale, Patient-reported outcomes summary scores as assessed by: -Selected question on symptomatic adverse events from the Patient-Reported Outcomes version of the Common Terminology Criteria Adverse Events (PRO-CTCAE) item library -The GP5 question on overall bother of side effects from the Functional Assessment of Cancer Therapy – Prostate questionnaire, PSA50 and PSA90 responses, PK parameters for xaluritamig such as maximum serum concentration (Cmax), time to maximum concentration (Tmax), minimum serum concentration (Cmin), area under the concentration-time curve (AUC) over the dosing interval, accumulation following multiple dosing, and, if feasible, half-life, Incidence of anti-xaluritamig antibody formation

Source: https://euclinicaltrials.eu/ctis-public/view/2024-513968-25-00